EU clinical trial 2022-502202-33-00: AttaCH: A Phase 2, Multicenter, Long-Term, Open Label Extension Trial Evaluating Safety, Tolerability, and Efficacy of Subcutaneous Doses of TransCon CNP Administered Once Weekly in Children and Adolescents with Achondroplasia
Protocol code: ASND0039
Sponsor: Ascendis Pharma Growth Disorders A/S (Pharmaceutical company). Phase: Therapeutic exploratory (Phase II). Countries: Denmark (ongoing, recruiting), Ireland (ongoing, recruiting), Austria (ongoing, recruiting), Germany (ongoing, recruiting), Portugal (ongoing, recruiting), Spain (ongoing, recruiting), Finland (authorised, recruitment pending), France (authorised, recruitment pending), Sweden (authorised, recruitment pending), Norway (authorised, recruitment pending).
Therapeutic area(s): Diseases [C] - Musculoskeletal Diseases [C05]
Gender: Female, Male. Age: 0-17 years. Enrolment: 152.
Start date (EU): 2023-07-06. Decision date: 2023-05-22. Results received: No. Last updated: 2026-05-19.
Decision dates by country: DK: 2023-05-22, IE: 2023-05-26, AT: 2023-09-04, DE: 2023-08-21, PT: 2023-08-21, ES: 2024-10-17, FI: 2026-04-16, FR: 2026-04-15, SE: 2026-04-14, NO: 2026-05-19

Condition(s): Achondroplasia in Children and Adolescents
Product: TransCon CNP 3.9 mg CNP-38/vial

Primary endpoint: Incidence of treatment emergent adverse events (TEAEs) [Time Frame: Through trial completion], Height Z-scores [Time Frame: Through trial completion]
Endpoint(s): Annualized growth velocity (AGV) (cm/year), Near final adult height [Time Frame: Through trial completion], Safety assessments: • Laboratory results of safety blood parameters • Vital signs (BP, HR, body temperature) • Abnormal physical examination findings • 12-lead electrocardiogram (ECG) • Tanner stage • Imaging assessments of bone age and bone related safety events (e.g. fracture, skeletal deformities, joint damage, slipped capital femoral epiphysis, avascular necrosis and osteonecrosis) • Tolerability and acceptability [Time Frame: Through trial completion], Plasma concentrations of Total CNP, Free CNP, and mPEG [Time Frame: Through treatment completion], Detection and analysis of anti-drug antibodies (ADAs) [Time Frame: Through trial completion]

Source: https://euclinicaltrials.eu/ctis-public/view/2022-502202-33-00